EU clinical trial 2023-508707-20-00: Neoadjuvant Triple Treatment with mFOLFIRINOX, pembrolizumab and SABR in patients with (borderline) resectable pancreatic cancer (PREOPANC-5): a multicenter single arm phase Ib/II trial of the Dutch Pancreatic Cancer Group
Protocol code: 2023-508707-20-00
Sponsor: Amsterdam UMC (Hospital/Clinic/Other health care facility). Phase: Phase I and Phase II (Integrated)- Other. Countries: Netherlands (ongoing, recruiting).
Therapeutic area(s): Analytical, Diagnostic and Therapeutic Techniques and Equipment [E] - Therapeutics [E02]; Diseases [C] - Neoplasms [C04]
Gender: Female, Male. Age: 18-64 years, 65+ years. Enrolment: 66.
Status: Ongoing, recruiting. Start date (EU): 2024-09-19. Decision date: 2024-04-29. Results received: No. Last updated: 2025-12-15.

Condition(s): Borderline resectable pancreatic cancer (BRPC), Pancreatic cancer, Resectable pancreatic cancer (RPC)
Product: Fluorouracil Accord 50 mg/ml, oplossing voor injectie of infusie, KEYTRUDA 25 mg/mL concentrate for solution for infusion, Irinotecan HCl-trihydraat Fresenius Kabi 20 mg/ml, concentraat voor oplossing voor infusie, Folikabi 10 mg/ml oplossing voor injectie/infusie, Oxaliplatine Fresenius Kabi 5 mg/ml concentraat voor oplossing voor infusie

Primary endpoint: Progression free survival, defined as the time from inclusion to the clinical trial to disease recurrence/progression or death from any cause
Endpoint(s): Overall survival, Resection rate, pR0 resection rate, Postoperative complications, Toxicity, Quality of life (QoL), Completion of neoadjuvant chemotherapy, Completion of neoadjuvant immunotherapy, Radiological response rate, Serum CA 19-9 response, Serum CEA response, Pathologic response, Immune responses, sR0 resection rate, Completion of adjuvant chemotherapy, Completion of neoadjuvant SABR, Completion of adjuvant immunotherapy, lymph node tumor-negative resection rate

Source: https://euclinicaltrials.eu/ctis-public/view/2023-508707-20-00